EU clinical trial 2024-515642-17-00: A phase 2 multi-center study investigating the efficacy, safety and tolerability of pioglitazone in adult participants with non-segmental vitiligo
Sponsor: I.F.O. Istituti Fisioterapici Ospitalieri (Hospital/Clinic/Other health care facility). Phase: Therapeutic exploratory (Phase II). Countries: Italy (not authorised).
Therapeutic area(s): Diseases [C] - Neoplasms [C04]
Gender: Female, Male. Age: 18-64 years. Enrolment: 74.
Status: Not authorised. Decision date: 2024-10-09. Results received: No. Last updated: 2024-10-09.

Condition(s): non-segmental vitiligo
Product: Pioglitazone Morningside 15mg Tablets

Primary endpoint: Proportion of subjects achieving VASI-50 (defined as at least 50% improvement in VASI from baseline) at Week 32. - Percent change from baseline in VASI, facial-VASI, vitiligo extent score (VES), and self-assessment VES (SA-VES) and absolute change from baseline in VASI at designated time points - Change from baseline in vitiligo specific quality of life (VitiQoL) and dermatology quality life index (DLQI) at designated time points.

Source: https://euclinicaltrials.eu/ctis-public/view/2024-515642-17-00